EU clinical trial 2024-516122-66-00: A phase II, single-arm study of de-escalation and treatment-free remission in patients with chronic myeloid leukemia treated with nilotinib in first-line therapy followed by a second attempt after nilotinib and asciminib combination: DANTE study
Protocol code: CAMN107AIT15
Sponsor: Novartis Farma S.p.A. (Pharmaceutical company). Phase: Therapeutic exploratory (Phase II). Countries: Italy (ended).
Therapeutic area(s): Diseases [C] - Neoplasms [C04]
Gender: Female, Male. Age: 18-64 years, 65+ years. Enrolment: 170.
Status: Ended. Start date (EU): 2019-01-18. End date (EU): 2025-10-15. Decision date: 2024-09-09. Results received: No. Last updated: 2025-07-09.

Condition(s): Chronic myeloid leukemia
Product: Scemblix 20 mg film-coated tablets, Tasigna 200 mg hard capsules, Scemblix 40 mg film-coated tablets, Tasigna 150 mg hard capsules

Primary endpoint: TFR1 stage: BCR-ABL ≤ 0.1% (IS) 96 weeks after the start of consolidation. TFR2 stage: BCR-ABL ≤ 0.1% (IS) 48 weeks after the start of TFR2.
Endpoint(s): TFR1 stage: Sustained DMR is defined as no loss of MR4.0 (BCR-ABL level ≤ 0.01% IS) in any BCR-ABL RQ-PCR assessment. The proportion of patients in sustained DMR at the end of consolidation (week 48) is calculated by dividing the number of patients in sustained DMR at week 48 by the number of patients who entered the consolidation period., DMR: ≥ MR 4.0 (BCR-ABL level ≤0.01% IS) at week 48, 96 and 144 after the start of the consolidation period. The proportion of patients in deep molecular response is calculated by dividing the number of patients in DMR 48, 96 and 144 weeks after the start of consolidation by the number of patients who entered the consolidation period., BCR-ABL ≤ 0.1% (IS) 144 weeks after consolidation. The proportion of patients in full treatment-free remission at week 144 is calculated by dividing the number of patients with no loss of MMR 144 weeks after the start of consolidation by the number of patients who entered the consolidation period., BCR-ABL ≤ 0.1% (IS) 48, 96, 144 weeks after the start of the consolidation. The proportion of patients with MMR at week 48, 96 and 144 is calculated by dividing the number of patients with MMR at week 48, 96 and 144, regardless of whether they required re-initiation of treatment after the start the study, by the number of patients who entered the consolidation., BCR-ABL transcript levels (IS) after restart of nilotinib therapy in patients who failed TFR1., BCR-ABL transcript levels (IS) after discontinuation of nilotinib therapy in patients in TFR1., BCR-ABL transcript levels (IS) during consolidation., FTFS: time from the start of consolidation to the earliest occurrence of any of the following events: loss of MMR, reinitiation of treatment due to any cause, progression to accelerated phase (AP)/blast crisis (BC), or death due to any cause., TFR rate: proportion of patients among those who entered TFR1 with no loss of MMR and no reinitiation of nilotinib after drug discontinuation at weeks 96 and 144 after the start of consolidation. The proportion of patients in TFR1 at weeks 96 and week 144 is calculated by dividing the number of patients with no loss of MMR and no reinitiation of nilotinib after drug discontinuation at weeks 96 and week 144 by the number of patients who entered TFR1., TFS: time from the start of TFR1 to the earliest occurrence of any of the following events: loss of MMR, reinitiation of treatment due to any cause, progression to AP/BC or death due to any cause., PFS: time from the start of consolidation to progression to AP/BC or death due to any cause, whichever occurs first., PFS: time from the start of TFR1 to progression to AP/BC or death due to any cause, whichever occurs first., OS: time from start of the study to death due to any cause., Type, frequency and severity of adverse events, laboratory values that fall outside of the pre-determined ranges and clinically notable ECG and other safety data during nilotinib treatment consolidation, TFR1, and during reinitiation of treatment with nilotinib., Successful FTFR and TFR - no loss of MMR and no reinitiation of nilotinib therapy in the first 96 weeks following the study start., Framingham risk score and SCORE at baseline, TFR2 stage: Eligibility is defined as sustained DMR, defined as no loss of MR4.0 (BCR-ABL level ≤ 0.01% IS) in any BCR-ABL RQ-PCR assessment. The proportion of eligible patients is calculated by dividing the number of eligible patients by the number of patients who entered reinduction., DMR: ≥ MR 4.0 (BCR-ABL level ≤0.01% IS); MMR: (BCR-ABL level ≤0.1% IS). The proportion of patients who regain MMR/DMR is calculated by dividing the number of patients in MMR/DMR 48 weeks after the start of TFR2 by the number of patients with loss of MMR in TFR2., BCR-ABL transcript levels (IS) during reinduction., BCR-ABL transcript levels (IS) after restart of nilotinib therapy in patients who failed TFR2 period., BCR-ABL transcript levels (IS) after restart of nilotinib therapy in patients who were not eligible for entering the TFR2 period., BCR-ABL transcript levels (IS) after discontinuation of asciminib + nilotinib therapy in patients in TFR2., TFS: time from the start of TFR2 stage to the earliest occurrence of any of the following events: loss of MMR, reinitiation of treatment due to any cause, progression to AP/BC or death due to any cause., PFS: time from the start of TFR2 stage to progression to AP/BC or death due to any cause, whichever occurs first., OS: time from start of reinduction to death due to any cause., Type, frequency and severity of adverse events, laboratory values that fall outside of the pre-determined ranges and clinically notable ECG and other safety data after the start of reinduction., Successful TFR2 - no loss of MMR and no reinitiation of nilotinib therapy starting from reinduction for TFR2., Framingham risk score and SCORE at the start of reinduction.

Source: https://euclinicaltrials.eu/ctis-public/view/2024-516122-66-00